EU clinical trial 2023-507669-24-00: A Phase 3b, Multicenter, Open-Label, Single-Arm Study of Acalabrutinib (ACP-196) in Subjects with Chronic Lymphocytic Leukemia
Protocol code: D8220C00008
Sponsor: Astrazeneca AB (Pharmaceutical company). Phase: Therapeutic confirmatory (Phase III). Countries: Norway (ended), Sweden (ended), Denmark (ended), Spain (ended), Netherlands (ended), Germany (ended), Finland (ended), Italy (ended), France (ended).
Therapeutic area(s): Diseases [C] - Neoplasms [C04]
Gender: Female, Male. Age: 18-64 years, 65+ years. Enrolment: 178.
Status: Ended. Start date (EU): 2019-11-05. End date (EU): 2025-11-04. End date: 2025-11-05. Decision date: 2024-05-23. Results received: Yes. Last updated: 2025-07-16.
Decision dates by country: DK: 2024-05-24, FI: 2024-05-28, FR: 2024-06-24, ES: 2024-05-24, SE: 2024-05-24, NL: 2024-05-23, NO: 2024-05-24, DE: 2024-05-24, IT: 2024-06-24

Condition(s): Chronic lymphocytic leukemia
Product: Calquence 100 mg hard capsules

Primary endpoint: Frequency, severity and relatedness of all AEs, which will also include: - Grade ≥3 AEs - SAEs - AESI defined as ventricular arrhythmias - AEs that lead to discontinuation of treatment - ECIs defined as cardiac events, hepatotoxicity, hypertension, infections, interstitial lung disease/pneumonitis, hemorrhage (major hemorrhage), cytopenias (anemia, leukopenia, thrombocytopenia), second primary malignancies, and tumor lysis syndrome.
Endpoint(s): Overall response; Duration of response; Progression-free survival.

Source: https://euclinicaltrials.eu/ctis-public/view/2023-507669-24-00